EU clinical trial 2024-518824-56-00: Pregabalin or Baclofen in Spastic Motor Behavior Treatment After SCI (PoBSCI), Prospective, Double-Blind, Randomised Drug Study
Protocol code: PoBSCI
Sponsor: Fakultni Nemocnice V Motole (Hospital/Clinic/Other health care facility). Phase: Therapeutic confirmatory (Phase III). Countries: Czechia (authorised, recruiting).
Therapeutic area(s): Diseases [C] - Musculoskeletal Diseases [C05]; Diseases [C] - Nervous System Diseases [C10]
Gender: Female, Male. Age: 18-64 years, 65+ years. Enrolment: 28.
Status: Authorised, recruiting. Start date (EU): 2026-05-26. Decision date: 2025-10-20. Results received: No. Last updated: 2025-10-20.

Condition(s): Complete to incomplete (AIS A-C) sub-acute cervical or thoracic (NLI C4-T10) spinal cord injury (SCI) with severe spastic motor behaviour
Product: Pregabalin Sandoz 50 mg hard capsules, BACLOFEN POLPHARMA 10 mg tablety

Primary endpoint: Per-patient average of MES scores across the 30 days treatment.
Endpoint(s): Per-patient average of MAS scores across the 30 days treatment, Proportion of days when MES score is 3 or higher., Proportion of days when MAS score is 3 or higher., ADL evaluated by SCI-SET (relevant questions)., Functioning assessed by the Spinal Cord Independence Measure (SCIM-III)., Quality of life evaluated by WHOQOL-BREF questionnaire.

Source: https://euclinicaltrials.eu/ctis-public/view/2024-518824-56-00